EU clinical trial 2023-510345-21-00: A study in healthy men and women to test how BI 3000202 is taken up and processed by the body
Protocol code: 1509-0010
Sponsor: Boehringer Ingelheim International GmbH (Pharmaceutical company). Phase: Human Pharmacology (Phase I)- Other. Countries: Netherlands (ended).
Therapeutic area(s): Not possible to specify
Gender: Female, Male. Age: 18-64 years. Enrolment: 16.
Status: Ended. Start date (EU): 2025-12-16. End date (EU): 2026-03-25. Decision date: 2025-12-12. Results received: No. Last updated: 2025-12-12.

Condition(s): Healthy volunteer trial

Source: https://euclinicaltrials.eu/ctis-public/view/2023-510345-21-00